EU clinical trial 2024-517421-12-00: A phase I, prospective, mono-center, double-blinded, randomized, controlled study to assess the safety and tolerability of intraarticular injection of PLX-PAD cells for the treatment of mild to moderate knee osteoarthritis – PROTO–I
Sponsor: Charite Universitaetsmedizin Berlin KöR (Hospital/Clinic/Other health care facility). Phase: Human Pharmacology (Phase I)- Other. Countries: Germany (temporarily halted).
Therapeutic area(s): Diseases [C] - Musculoskeletal Diseases [C05]
Gender: Female, Male. Age: 18-64 years, 65+ years. Enrolment: 18.
Status: Temporarily halted. Start date (EU): 2026-01-07. Decision date: 2025-05-30. Results received: No. Last updated: 2026-07-21.

Condition(s): Osteoarthritis

Source: https://euclinicaltrials.eu/ctis-public/view/2024-517421-12-00